EU clinical trial 2024-518702-40-00: A three-arm randomized controlled non-inferiority pilot study Comparing Anticoagulation Strategies using Unfractionated heparin, Argatroban and Low-molecular-weight heparin for Extracorporeal Membrane Oxygenation support
Sponsor: Medical University Of Vienna (Educational Institution). Phase: Therapeutic use (Phase IV). Countries: Austria (ongoing, recruiting).
Therapeutic area(s): Diseases [C] - Virus Diseases [C02]; Diseases [C] - Cardiovascular Diseases [C14]; Diseases [C] - Bacterial Infections and Mycoses [C01]; Diseases [C] - Respiratory Tract Diseases [C08]
Gender: Female, Male. Age: 18-64 years, 65+ years. Enrolment: 90.
Status: Ongoing, recruiting. Start date (EU): 2024-06-17. Decision date: 2024-12-11. Results received: No. Last updated: 2026-06-30.

Condition(s): Respiratory Insufficiency, Respiratory Failure, Circulatory Failure, Acute Respiratory Distress Syndrome
Product: Argatra Multidose 100 mg/ml Konzentrat zur Herstellung einer Infusionslösung., Heparin Gilvasan 1000 IE/ml – Injektions-/Infusionslösung, Inhixa 100,000 IU (1000 mg)/10 mL solution for injection in multidose container

Primary endpoint: Incidence of thromboembolic events during ECMO therapy i.e.: • Clinically relevant thromboembolic events (Clinical suspicion; confirmation via imaging) • Pulmonary embolism, deep vein thrombosis • Intracardiac thrombosis • Arterial thromboembolism including myocardial and cerebral infarction • Deep vein thrombosis (detected during daily routine sonography) • Need to exchange ECMO circuit due to acute or incipient clotting
Endpoint(s): Incidence of bleeding events classified according to BARC Criteria

Source: https://euclinicaltrials.eu/ctis-public/view/2024-518702-40-00